EU clinical trial 2024-518285-27-00: A Phase I double blinded, single-center, randomized, crossover study comparing the PK, PD, safety and tolerability of a single IV dose (1µg/kg) of LB-0702 and Nplate® in healthy volunteers.
Protocol code: RJ-ROM01
Sponsor: Laboratorio Reig Jofre S.A. (Pharmaceutical company). Phase: Human Pharmacology (Phase I)- Bioequivalence Study. Countries: Spain (ongoing, recruiting).
Therapeutic area(s): Not possible to specify
Gender: Male. Age: 18-64 years. Enrolment: 34.
Status: Ongoing, recruiting. Start date (EU): 2025-12-01. Decision date: 2025-03-18. Results received: No. Last updated: 2025-08-06.

Condition(s): Not applicable (submitted trial is a bioequivalence study)

Source: https://euclinicaltrials.eu/ctis-public/view/2024-518285-27-00